EU clinical trial 2024-516034-35-00: A double blinded, balanced, randomized, two-treatment, two-period, two-sequence, single dose, crossover, bioequivalence study comparing Bupropion Hydrochloride Sustained-Release Tablets 150 mg, manufactured for Sun Pharmaceutical Industries Limited, India with PrOdan Bupropion SR (Bupropion Hydrochloride Sustained-Release Tablets 150 mg), product of Odan Laboratories Ltd., 325 Stillview Avenue, Pointe Claire, Quebec, H9R 2Y6, in healthy adult, human subjects under fasting condition.
Protocol code: BUPRO-07-24
Sponsor: Sun Pharmaceutical Industries Limited (Pharmaceutical company). Phase: Human Pharmacology (Phase I)- Bioequivalence Study. Countries: Romania (ended).
Therapeutic area(s): Psychiatry and Psychology [F] - Mental Disorders [F03]
Gender: Female, Male. Age: 18-64 years. Enrolment: 56.
Status: Ended. Start date (EU): 2025-12-05. End date (EU): 2026-02-17. Decision date: 2025-10-27. Results received: No. Last updated: 2025-10-27.

Condition(s): major depressive illness

Source: https://euclinicaltrials.eu/ctis-public/view/2024-516034-35-00